EU clinical trial 2025-521572-56-00: EFFICACY OF VASOCONSTRICTOR PERIARTICULAR INFILTRATION (PIV) VERSUS ERECTOR SPINAE PLANE BLOCK (ESP) IN REDUCING BLEEDING AND POSTOPERATIVE PAIN CONTROL IN LUMBAR ARTHRODESIS SURGERY. RANDOMIZED CLINICAL TRIAL.
Protocol code: IIBSP-IPV-2024-178
Sponsor: Fundacio Institut De Recerca De L'Hospital De La Santa Creu I Sant Pau (Hospital/Clinic/Other health care facility). Phase: Therapeutic confirmatory (Phase III). Countries: Spain (ongoing, recruiting).
Therapeutic area(s): Diseases [C] - Nervous System Diseases [C10]; Analytical, Diagnostic and Therapeutic Techniques and Equipment [E] - Anesthesia and Analgesia [E03]
Gender: Female, Male. Age: 18-64 years, 65+ years. Enrolment: 62.
Status: Ongoing, recruiting. Start date (EU): 2026-01-08. Decision date: 2025-08-07. Results received: No. Last updated: 2026-01-16.

Condition(s): lumbar arthrodesis
Product: Ropivacaína Altan 2 mg/ml solución inyectable EFG, Adrenalina B. Braun 1 mg/ml Solución Inyectable

Primary endpoint: The primary variable will be intraoperative bleeding in the two study groups, calculated based on the suctioned fluids from the surgical field and the gauzes after extracting the irrigation fluids. Bleeding will be measured in milliliters (ml). The research team will collect the data from the anesthesia record of the procedure.

Source: https://euclinicaltrials.eu/ctis-public/view/2025-521572-56-00